EU clinical trial 2022-502922-41-00: Long-term safety and efficacy of semaglutide s.c. once-weekly on weight management in children and adolescents (aged 6 to <18 years) with obesity or overweight
Protocol code: NN9536-4512
Sponsor: Novo Nordisk A/S (Pharmaceutical company). Phase: Therapeutic confirmatory (Phase III). Countries: Belgium (ongoing, recruitment ended), Portugal (ongoing, recruitment ended), Sweden (ongoing, recruitment ended), Germany (ongoing, recruitment ended), Austria (ongoing, recruitment ended), Denmark (ongoing, recruitment ended).
Therapeutic area(s): Diseases [C] - Nutritional and Metabolic Diseases [C18]
Gender: Female, Male. Age: 0-17 years. Enrolment: 86.
Status: Ongoing, recruitment ended. Start date (EU): 2023-07-03. Decision date: 2023-06-13. Results received: No. Last updated: 2026-03-30.
Decision dates by country: AT: 2023-06-19, BE: 2023-06-13, DE: 2023-06-19, DK: 2023-08-23, PT: 2023-06-14, SE: 2023-06-15

Condition(s): Obesity and overweight
Product: Wegovy 0.5 mg FlexTouch solution for injection in pre-filled pen, Placebo (semaglutide B 1.5 mL), Wegovy 1 mg FlexTouch solution for injection in pre-filled pen, Wegovy 1.7 mg FlexTouch solution for injection in pre-filled pen, Wegovy 2.4 mg FlexTouch solution for injection in pre-filled pen, Placebo (semaglutide B 3.0 mL), Wegovy 0.25 mg FlexTouch solution for injection in pre-filled pen, Wegovy 2.4 mg FlexTouch solution for injection in pre-filled pen

Primary endpoint: [Group Kids] Change in BMI, Baseline (week 0) to week 68
Endpoint(s): [Group Kids] [Confirmatory secondary endpoint], Improvement in weight category (Based on CDC sex- and age-specific growth charts), Baseline (week 0) to week 68, [Group Kids] [Supportive secondary endpoint] Change in BMI, Week 0 to week 104, [Group Kids] [Supportive secondary endpoint] Improvement in weight category (Based on CDC sex- and age-specific growth charts), Week 0 to week 104, [Group Kids] [Supportive secondary endpoint] Change in body weight, Week 0 to week 68, Week 0 to week 104, [Group Kids] [Supportive secondary endpoint] Change in BMI percentage of the 95th percentile (Based on CDC sex- and age-specific growth charts), Week 0 to week 68, Week 0 to week 104, [Group Kids] [Supportive secondary endpoint] Change in BMI, SDS (standard deviation score) [As defined by the WHO BMI-for-age growth reference chart], Week 0 to week 68, Week 0 to week 104, [Group Kids] [Supportive secondary endpoint] Change in waist circumference, Week 0 to week 68, Week 0 to week 104, [Group Kids] [Supportive secondary endpoint] Change in systolic blood pressure, Week 0 to week 68, Week 0 to week 104, [Group Kids] [Supportive secondary endpoint] Change in diastolic blood pressure, Week 0 to week 68, Week 0 to week 104, [Group Kids] [Supportive secondary endpoint] Change in total cholesterol, Week 0 to week 68, Week 0 to week 104, [Group Kids] [Supportive secondary endpoint] Change in HDL, Week 0 to week 68, Week 0 to week 104, [Group Kids] [Supportive secondary endpoint] Change in LDL, Week 0 to week 68, Week 0 to week 104, [Group Kids] [Supportive secondary endpoint] Change in VLDL, Week 0 to week 68, Week 0 to week 104, [Group Kids] [Supportive secondary endpoint] Change in triglycerides, Week 0 to week 68, Week 0 to week 104, [Group Kids] [Supportive secondary endpoint] Change in hs-CRP, Week 0 to week 68, Week 0 to week 104, [Group Kids] [Supportive secondary endpoint] Change in HbA1c, Week 0 to week 68, Week 0 to week 104, [Group Kids] [Supportive secondary endpoint] Change in fasting plasma glucose, Week 0 to week 68, Week 0 to week 104, [Group Kids] [Supportive secondary endpoint] Change in fasting insulin, Week 0 to week 68, Week 0 to week 104, Change in ALT, Week 0 to week 68, Week 0 to week 104, [Group Kids] [Supportive secondary endpoint] Change in total fat mass, by DXA (For the population who have DXA scans) relative to total body mass, Week 0 to week 68, Week 0 to week 104, [Group Kids] [Supportive secondary endpoint] Change in lean body mass, by DXA (For the population who have DXA scans) relative to total body mass, Week 0 to week 68, Week 0 to week 104, [Group Kids] [Supportive secondary endpoint] Relative change in visceral fat mass by DXA (For the population who have DXA scans), Week 0 to week 68, Week 0 to week 104, [Group Kids] [Supportive secondary endpoint] Participants achieving ≥5% reduction of BMI (yes/no), Week 0 to week 68, Week 0 to week 104, [Group Kids] [Supportive secondary endpoint] Participants achieving ≥10% reduction of BMI (yes/no), Week 0 to week 68, Week 0 to week 104, Participants achieving ≥15% reduction of BMI (yes/no), Week 0 to week 68, Week 0 to week 104, [Group Teens] [Supportive secondary endpoint] Change in BMI, Week 0 to week 68, Week 0 to week 104, [Group Teens] [Supportive secondary endpoint] Improvement in weight category (Based on CDC sex- and age-specific growth charts), Week 0 to week 68, Week 0 to week 104, [Group Teens] [Supportive secondary endpoint] Change in body weight, Week 0 to week 68, Week 0 to week 104, [Group Teens] [Supportive secondary endpoint] Change in BMI percentage of the 95th percentile (Based on CDC sex- and age-specific growth charts), Week 0 to week 68, Week 0 to week 104, [Group Teens] [Supportive secondary endpoint] Change in BMI, SDS (standard deviation score) [As defined by the WHO BMI-for-age growth reference chart], Week 0 to week 68, Week 0 to week 104, [Group Teens] [Supportive secondary endpoint] Change in waist circumference, Week 0 to week 68, Week 0 to week 104, [Group Teens] [Supportive secondary endpoint] Change in systolic blood pressure, Week 0 to week 68, Week 0 to week 104, [Group Teens] [Supportive secondary endpoint] Change in diastolic blood pressure, Week 0 to week 68, Week 0 to week 104, [Group Teens] [Supportive secondary endpoint] Change in total cholesterol, Week 0 to week 68, Week 0 to week 104, [Group Teens] [Supportive secondary endpoint] Change in HDL, Week 0 to week 68, Week 0 to week 104, [Group Teens] [Supportive secondary endpoint] Change in LDL, Week 0 to week 68, Week 0 to week 104, [Group Teens] [Supportive secondary endpoint] Change in VLDL, Week 0 to week 68, Week 0 to week 104, [Group Teens] [Supportive secondary endpoint] Change in triglycerides, Week 0 to week 68, Week 0 to week 104, [Group Teens] [Supportive secondary endpoint] Change in hs-CRP, Week 0 to week 68, Week 0 to week 104, [Group Teens] [Supportive secondary endpoint] Change in HbA1c, Week 0 to week 68, Week 0 to week 104, [Group Teens] [Supportive secondary endpoint] Change in fasting plasma glucose, Week 0 to week 68, Week 0 to week 104, [Group Teens] [Supportive secondary endpoint] Change in fasting insulin, Week 0 to week 68, Week 0 to week 104, [Group Teens] [Supportive secondary endpoint] Change in ALT, Week 0 to week 68, Week 0 to week 104, [Group Teens] [Supportive secondary endpoint] Change in total fat mass, by DXA (For the population who have DXA scans) relative to total body mass, Week 0 to week 68, Week 0 to week 104, Change in lean body mass, by DXA (For the population who have DXA scans) relative to total body mass, Week 0 to week 68, Week 0 to week 104, [Group Teens] [Supportive secondary endpoint] Relative change in visceral fat mass by DXA (For the population who have DXA scans), Week 0 to week 68, Week 0 to week 104, [Group Teens] [Supportive secondary endpoint] Participants achieving ≥5% reduction of BMI (yes/no), Week 0 to week 68, Week 0 to week 104, [Group Teens] [Supportive secondary endpoint] Participants achieving ≥10% reduction of BMI (yes/no), Week 0 to week 68, Week 0 to week 104, [Group Teens] [Supportive secondary endpoint] Participants achieving ≥15% reduction of BMI (yes/no), Week 0 to week 68, Week 0 to week 104, Treatment emergent AEs, Week 0 to week 68, Week 0 to week 111, Treatment emergent SAEs, Week 0 to week 68, Week 0 to week 111, Change in pulse Week 0 to week 68, Week 0 to week 104, Change in amylase, Week 0 to week 68, Week 0 to week 104, Change in lipase, Week 0 to week 68, Week 0 to week 104, Change in calcitonin, Week 0 to week 68, Week 0 to week 104, Change in bone mineral density, by DXA (For the population who have DXA scans), Treatment emergent hypoglycaemic episodes (for T2D only) [As defined by ISPAD]

Source: https://euclinicaltrials.eu/ctis-public/view/2022-502922-41-00